EU clinical trial 2025-523130-11-00: A Phase 1, Open-Label, Multicenter Study of INCA036873 in Participants With Advanced Solid Tumors and Hematological Malignancies
Protocol code: INCA036873-101
Sponsor: Incyte Corp. (Pharmaceutical company). Phase: Human Pharmacology (Phase I)- First administration to humans. Countries: Italy (authorised, recruitment pending), Belgium (authorised, recruitment pending), Denmark (authorised, recruitment pending).
Therapeutic area(s): Diseases [C] - Neoplasms [C04]
Gender: Female, Male. Age: 18-64 years, 65+ years. Enrolment: 150.
Status: Authorised, recruitment pending. Decision date: 2026-06-16. Results received: No. Last updated: 2026-06-17.
Decision dates by country: BE: 2026-06-16, DK: 2026-06-17, IT: 2026-06-16

Condition(s): Hematological malignancies, Advanced solid tumors

Source: https://euclinicaltrials.eu/ctis-public/view/2025-523130-11-00